EU clinical trial 2024-510942-15-00: BCS-ORL - Evaluation of the superficial cervical plexus block in oncological throat and neck surgery
Protocol code: APHP230866
Sponsor: Assistance Publique Hopitaux De Paris (Hospital/Clinic/Other health care facility). Phase: Therapeutic confirmatory (Phase III). Countries: France (ongoing, recruiting).
Therapeutic area(s): Analytical, Diagnostic and Therapeutic Techniques and Equipment [E] - Anesthesia and Analgesia [E03]; Diseases [C] - Otorhinolaryngologic Diseases [C09]
Gender: Female, Male. Age: 18-64 years, 65+ years. Enrolment: 346.
Status: Ongoing, recruiting. Start date (EU): 2026-04-07. Decision date: 2025-05-28. Results received: No. Last updated: 2025-05-28.

Condition(s): Cancer surgery
Product: SODIUM CHLORIDE, ROPIVACAINE

Primary endpoint: Quantity of morphine consumed postoperatively (quantity of morphine titrated in postoperative room + administered by the PCA in mg and mg/kg/d).

Source: https://euclinicaltrials.eu/ctis-public/view/2024-510942-15-00